EU clinical trial 2024-516440-25-00: A study to characterise the safety, tolerability and efficacy of LY3962673 in subjects with advanced solid tumors.
Protocol code: J5J-OX-JZZA
Sponsor: Eli Lilly & Co. (Pharmaceutical company). Phase: Human Pharmacology (Phase I)- First administration to humans. Countries: Germany (ongoing, recruiting), Ireland (ongoing, recruiting), Spain (ongoing, recruiting), Italy (ongoing, recruiting).
Therapeutic area(s): Diseases [C] - Neoplasms [C04]
Gender: Female, Male. Age: 18-64 years, 65+ years. Enrolment: 190.
Status: Ongoing, recruiting. Start date (EU): 2025-02-06. Decision date: 2025-01-20. Results received: No. Last updated: 2026-03-09.
Decision dates by country: IE: 2025-01-24, DE: 2025-01-21, ES: 2025-01-20, IT: 2025-01-21

Condition(s): KRAS G12D-mutant solid tumors.

Source: https://euclinicaltrials.eu/ctis-public/view/2024-516440-25-00